EU clinical trial 2024-511388-27-04: Add-on Clioquinol in drug-resistant epilepsy: an exploratory study
Protocol code: CLIOKIDA
Sponsor: UZ Leuven (Hospital/Clinic/Other health care facility). Phase: Therapeutic exploratory (Phase II). Countries: Belgium (ongoing, recruiting).
Therapeutic area(s): Diseases [C] - Musculoskeletal Diseases [C05]; Diseases [C] - Nervous System Diseases [C10]
Gender: Female, Male. Age: 0-17 years, 18-64 years. Enrolment: 20.
Status: Ongoing, recruiting. Start date (EU): 2024-07-16. Decision date: 2024-07-16. Results received: No. Last updated: 2025-10-29.

Condition(s): Drug resistant epilepsy
Product: Clioquinol

Primary endpoint: Percentage of 50% responders after 2 weeks and 6 weeks exposure to low and higher doses of clioquinol respectively (visit 3 and visit 5), Median % reduction of the seizure frequency at visit 5
Endpoint(s): Safety during trial (systematic recording of adverse events) Clinical neurological examination during the trial will identify children with possible neuropathy Adverse events will be reported (clinical and biochemical)., Assessment of seizure severity (NHS3 scale), Assessment of overall impact of seizures, medication side effects, comorbidities, and overall QoL (PIES).

Source: https://euclinicaltrials.eu/ctis-public/view/2024-511388-27-04